EU clinical trial 2024-513007-14-00: Improving Peptide Receptor Radionuclide Therapy with PARP inhibitors
Protocol code: NL79259.078.21
Sponsor: Erasmus Universitair Medisch Centrum Rotterdam (Erasmus MC) (Hospital/Clinic/Other health care facility). Phase: Human Pharmacology (Phase I)- Other. Countries: Netherlands (ongoing, recruiting).
Therapeutic area(s): Diseases [C] - Digestive System Diseases [C06]; Diseases [C] - Hormonal diseases [C19]
Gender: Female, Male. Age: 18-64 years. Enrolment: 24.
Status: Ongoing, recruiting. Start date (EU): 2022-03-24. Decision date: 2024-05-28. Results received: No. Last updated: 2024-05-28.

Condition(s): locally advanced or metastatic, well-differentiated gastro-enteropancreatic neuroendocrine tumors.

Source: https://euclinicaltrials.eu/ctis-public/view/2024-513007-14-00